EU clinical trial 2024-516148-24-00: A phase III, randomized, double-blinded study of the efficacy and safety of LEvetiracetam to prevent Seizures in Symptomatic Alzheimer's Disease in adults with Down syndrome (the LESS-AD trial).
Sponsor: Fundacio Institut De Recerca De L'Hospital De La Santa Creu I Sant Pau (Hospital/Clinic/Other health care facility). Phase: Therapeutic confirmatory (Phase III). Countries: Spain (ongoing, recruiting).
Therapeutic area(s): Diseases [C] - Nervous System Diseases [C10]; Analytical, Diagnostic and Therapeutic Techniques and Equipment [E] - Therapeutics [E02]; Phenomena and Processes [G] - Genetic Phenomena [G05]
Gender: Female, Male. Age: 18-64 years, 65+ years. Enrolment: 120.
Status: Ongoing, recruiting. Start date (EU): 2025-12-16. Decision date: 2025-05-06. Results received: No. Last updated: 2025-11-04.

Condition(s): Down syndrome, Alzheimer's Disease
Product: Levetiracetam NORMON 250 mg comprimidos recubiertos con película EFG, PLACEBO LEVETIRACETAM 250 mg, Levetiracetam NORMON 500 mg comprimidos recubiertos con película EFG, PLACEBO LEVETIRACETAM 500 mg

Primary endpoint: Efficacy: Number (percentage) of subjects who do not develop a bilateral tonic-clonic epileptic seizure during the study (96 weeks). Therefore, a non-responder, or treatment failure, is defined as any subject who develops a bilateral tonic-clonic epileptic seizure during the study.
Endpoint(s): Time to first bilateral tonic-clonic epileptic seizure (days), All-cause mortality: - Number (percentage) of patients dying from any cause during the study. - Number (percentage) of patients dying due to AD complications during the study. - Time to death (days)., AD-related biomarkers: - Cognition: The neuropsychological assessment will include the CAMCOG-DS, mCRT, Plasma biomarkers: plasma concentrations of 217-pTau and NfL (pg/mL)., Neuroimaging biomarkers (MRI): Volumetric measures extracted for 12 subcortical gray matter regions (six left and six right, including the amygdala, caudate nucleus accumbens, pallidum, putamen, and thalamus), the left and right hippocampi, and the left and right lateral ventricles. Cortical thickness measure extracted for 34 left-hemispheric gray matter regions, and 34 right hemispheric gray matter regions (Whelan et al, Brain 2018)., Electroencephalography (EEG): Appearance of graphoelements with irritative characteristics: spike-wave, polyspike-wave, acute wave and spike or focal and generalized slowing of the activity, power spectrum analysis and synchronization by bands., - Safety: The primary endpoints are number, type, frequency, and intensity of AEs evaluated until the end of treatment and assessment of tolerability during the medical visit, physical and neurological examination, vital signs, brain MRI assessment, suicidality (as measured with the C-SSRS), routine hematology and biochemistry evaluation in blood.

Source: https://euclinicaltrials.eu/ctis-public/view/2024-516148-24-00